EU clinical trial 2023-508811-21-00: A Phase 2/3 Multicenter, Randomized, Double-Blind, Placebo-Controlled, Study to Evaluate the Efficacy, Safety and Tolerability of BHV-7000 in Subjects with Refractory Focal Onset Epilepsy
Protocol code: BHV7000-303
Sponsor: Biohaven Therapeutics Ltd. (Pharmaceutical company). Phase: Phase II and Phase III (Integrated). Countries: Finland (ongoing, recruitment ended), Portugal (ongoing, recruitment ended), Spain (ongoing, recruitment ended), Germany (ongoing, recruitment ended), Italy (ongoing, recruitment ended), Denmark (ongoing, recruitment ended), Greece (ongoing, recruitment ended), Romania (ongoing, recruitment ended), Slovakia (ongoing, recruitment ended), Hungary (ongoing, recruitment ended), Poland (ongoing, recruitment ended).
Therapeutic area(s): Diseases [C] - Nervous System Diseases [C10]
Gender: Female, Male. Age: 18-64 years, 65+ years. Enrolment: 274.
Status: Ongoing, recruitment ended. Start date (EU): 2024-09-25. Decision date: 2024-09-02. Results received: No. Last updated: 2026-07-27.
Decision dates by country: DK: 2024-09-05, GR: 2025-05-02, PT: 2024-09-09, ES: 2024-09-05, HU: 2026-01-07, IT: 2024-09-03, DE: 2024-09-03, SK: 2025-06-02, PL: 2026-02-08, RO: 2025-06-10, FI: 2024-09-02

Condition(s): Refractory Focal Onset Epilepsy
Product: BHV-7000, Placebo BHV-7000, BHV-7000, Placebo for BHV-7000

Primary endpoint: - Proportion of subjects with at least a 50% reduction in 28-day average seizure frequency over the course of the DBP compared to the OP for the 75 mg dose of BHV7000 and placebo.
Endpoint(s): Change in log-transformed 28-day adjusted seizure frequency from OP over the 8-week DBP for the 75 mg dose of BHV-7000 and placebo., - Change in log-transformed 28-day adjusted seizure frequency from OP over the 8-week DBP for the 50 mg dose of BHV-7000 and placebo., -Proportion of subjects with at least a 50% reduction in 28-day average seizure frequency over the course of the DBP compared to the OP for the 50 mg dose of BHV-7000 and placebo., - Safety is assessed by the number of unique subjects with deaths, SAEs, AEs leading to discontinuation, moderate and severe AEs and grade 3 and 4 laboratory abnormalities.

Source: https://euclinicaltrials.eu/ctis-public/view/2023-508811-21-00